EU clinical trial 2023-504514-29-00: A study of ASP2138 given by itself or given with other cancer treatments in adults with stomach cancer, gastroesophageal junction cancer, or pancreatic cancer
Protocol code: 2138-CL-0101
Sponsor: Astellas Pharma Global Development Inc. (Pharmaceutical company). Phase: Human Pharmacology (Phase I)- First administration to humans. Countries: Italy (ongoing, recruiting), France (ongoing, recruiting), Spain (ongoing, recruiting).
Therapeutic area(s): Diseases [C] - Neoplasms [C04]
Gender: Female, Male. Age: 18-64 years, 65+ years. Enrolment: 100.
Status: Ongoing, recruiting. Start date (EU): 2024-06-18. Decision date: 2024-01-25. Results received: No. Last updated: 2026-02-10.
Decision dates by country: FR: 2024-04-29, ES: 2025-03-31, IT: 2024-01-25

Condition(s): Gastroesophageal Junction (GEJ) Adenocarcinoma, Gastric Adenocarcinoma, Pancreatic Adenocarcinoma

Source: https://euclinicaltrials.eu/ctis-public/view/2023-504514-29-00